EU clinical trial 2024-514848-88-00: BOOSTERS - BiOlogics in FOlliculitis decalvanS : an adaptaTivE tRial reSearch
Protocol code: APHP230831
Sponsor: Assistance Publique Hopitaux De Paris (Hospital/Clinic/Other health care facility). Phase: Therapeutic exploratory (Phase II). Countries: France (authorised, recruitment pending).
Therapeutic area(s): Analytical, Diagnostic and Therapeutic Techniques and Equipment [E] - Therapeutics [E02]; Diseases [C] - Skin and Connective Tissue Diseases [C17]
Gender: Female, Male. Age: 18-64 years. Enrolment: 120.
Status: Authorised, recruitment pending. Decision date: 2025-11-24. Results received: No. Last updated: 2026-05-12.

Condition(s): Folliculitis decalvans
Product: ADALIMUMAB, USTEKINUMAB, ADALIMUMAB, USTEKINUMAB, Olumiant 4 mg film-coated tablets

Primary endpoint: The primary endpoint is an IGA score (FD-IGA) which will be assessed by a blinded assessor. Success will be defined by at least a decrease of 2 points of the FD-IGA at 6 months.
Endpoint(s): Pain evaluated by Visual Analogue Scale (VAS) at randomization, 3, 6 and 12 months. Pain change from randomization, at 3, 6 and 12 months., Pruritus evaluated by WI-NRS (Worst Itch Numeric Rating Scale) at randomization, 3, 6 and 12 months, Quality of life evaluated by Dermatology life quality index (DLQI) at randomization, 3, 6 and 12 months, Time to first relapse during the study period, Measure of FD-IGA score in the population of patients receiving the antibiotic rescue (at the onset of the rescue), Measure of FD-IGA score (blinded assessor) at 12 months, Tolerance of drugs

Source: https://euclinicaltrials.eu/ctis-public/view/2024-514848-88-00